EU clinical trial 2023-505520-61-00: A Phase 2a, Multicenter, Randomized, Double-blind, Placebo-controlled Study to Evaluate the Efficacy and Safety of MK-6194 in Adult Participants With Systemic Lupus Erythematosus
Protocol code: MK-6194-006
Sponsor: Merck Sharp & Dohme LLC (Pharmaceutical company). Phase: Phase II and Phase III (Integrated). Countries: France (ended), Spain (ended), Poland (ended), Italy (ended).
Therapeutic area(s): Diseases [C] - Immune System Diseases [C20]
Gender: Female, Male. Age: 18-64 years, 65+ years. Enrolment: 69.
Status: Ended. Start date (EU): 2024-03-11. End date (EU): 2025-06-30. End date: 2025-07-30. Decision date: 2024-02-26. Results received: Yes. Last updated: 2025-07-23.
Decision dates by country: FR: 2024-02-29, IT: 2024-02-26, PL: 2024-02-29, ES: 2024-02-26

Condition(s): Systemic Lupus Erythematosus
Product: MK-6194, Placebo for MK-6194

Primary endpoint: Percentage of Participants Achieving Systemic Lupus Erythematosus Responder Index (SRI-4) Response at Week 28, Percentage of Participants Experiencing Adverse Events (AEs), Percentage of Participants Discontinuing Study Treatment Due to an AE
Endpoint(s): Percentage of Participants Achieving British Isles Lupus Assessment Group (BILAG)-based Composite Lupus Assessment Response (BICLA) at Week 28, Percentage of Participants Achieving SRI-4 Response at Week 52, Percentage of Participants Achieving BICLA at Week 52, Percentage of Participants with a Cutaneous Lupus Erythematosus Disease Area and Severity Index (CLASI)-50 Response at Week 28, Percentage of Participants with a CLASI-50 Response at Week 52, Change From Baseline of 28 Joint Count at Week 28, Change From Baseline of 28 Joint Count at Week 52, Change From Baseline of Corticosteroid Dose at Week 28, Change From Baseline of Corticosteroid Dose at Week 52, Cumulative Oral Corticosteroid Use Between Week 0 to Week 28, Cumulative Oral Corticosteroid Use Between Week 0 to Week 52, Percentage of Participants Who Achieve Low Level of Disease Activity (LLDAS) at Week 28, Percentage of Participants Who Achieve LLDAS at Week 52

Source: https://euclinicaltrials.eu/ctis-public/view/2023-505520-61-00